EU clinical trial 2023-506826-36-00: A randomized, placebo-controlled, double-blind, 3-period cross-over study in youth with autism spectrum disorders evaluating neural plasticity and learning after a single administration of intranasal oxytocin
Sponsor: Oslo University Hospital HF (Hospital/Clinic/Other health care facility). Phase: Therapeutic exploratory (Phase II). Countries: Norway (ongoing, recruiting).
Therapeutic area(s): Psychiatry and Psychology [F] - Psychological Phenomena [F02]; Psychiatry and Psychology [F] - Behavior and Behavior Mechanisms [F01]
Gender: Female, Male. Age: 0-17 years, 18-64 years. Enrolment: 98.
Status: Ongoing, recruiting. Start date (EU): 2026-01-26. Decision date: 2024-05-23. Results received: No. Last updated: 2026-06-02.

Condition(s): Autism spectrum disorder
Product: SYNTOCINON® 6,7 mikrog/dose nesespray, oppløsning, Natriumklorid Fresenius Kabi 9 mg/ml infusjonsvæske, oppløsning, OXYTOCIN

Primary endpoint: Neural plasticity will be evaluated using EEG 40 minutes after intervention administration. The visual evoked potential (VEP) paradigm will be used to probe neural plasticity. An increase in neural plasticity will be measured by a statistically significant amplitude modulation when compared to placebo in the following components: C1, P1, N1, N1b and P2. H1: There is a difference between placebo and active treatments. H0: There is no significant difference between placebo and active treatments., Cognitive flexibility will be evaluated behaviourally using the computerized probabilistic reversal learning task. An increase in task performance is measured as a statistically significant decrease in number of incorrect trials and total number of trials needed to reach the learning criterion. H1: There is a difference between placebo and active treatments. H0: There is no significant difference between placebo and active treatments).
Endpoint(s): Heart rate variability (HRV), measured using electrocardiogram (ECG) 60 minutes after intervention administration. H1: There is a difference in HRV between placebo and active treatments. H0: There is no significant difference in HRV between placebo and active treatments), The potential moderating effect on intervention response of symptom severity, as indexed by the Social Responsiveness ScaleSecond Edition, Repetitive Behaviour ScaleRevised, Behavioral Inflexibility scale and The Autism Behaviour Inventory. H1: Higher disorder severity will be associated with increased oxytocin treatment response. H0: H0: There is no significant positive association between disorder severity with oxytocin treatment response.

Source: https://euclinicaltrials.eu/ctis-public/view/2023-506826-36-00